EU clinical trial 2024-519848-33-00: Serotonin role on brain circuits involved in food avoidance in anorexia nervosa : Study of Gaze control and multimodal Brain imaging.
Protocol code: 20CH240
Sponsor: Centre Hospitalier Universitaire De Saint Etienne (Hospital/Clinic/Other health care facility). Phase: Therapeutic confirmatory (Phase III). Countries: France (ended).
Therapeutic area(s): Analytical, Diagnostic and Therapeutic Techniques and Equipment [E] - Diagnosis [E01]
Gender: Female. Age: 0-17 years, 18-64 years. Enrolment: 75.
Status: Ended. End date (EU): 2025-07-08. Decision date: 2025-01-30. Results received: No. Last updated: 2025-11-24.

Condition(s): Anorexia Nervosa
Product: 3-AMINO-4-[2-[[METHYL((111C)METHYL)AMINO]METHYL]PHENYL]SULFANYLBENZONITRILE

Primary endpoint: BPND, the unit for measuring the non-displaceable binding potential of the [11C] DASB in PET imaging
Endpoint(s): Resting-state functional MRI measurement of cerebral blood flow quantified by ArterialSpin Labelling (ASL) to assess cerebral perfusion (regional cerebral blood flow)., Resting-state MRI measurement of water diffusion in white matter to assess structural brain connectivity structural brain connectivity, in DTI (diffusion tensor imaging) mode, Resting-state functional MRI measurement of white matter water Diffusion for the assessment of structural structural brain connectivity, in DTI (diffusion tensor imaging) mode, Functional MRI measurement of brain activity levels by BOLD in the resting state and during task performance simultaneously with PET acquisition, thanks to the hybrid PET-MRI CAMERA., The subjects' responses (subjective measures) to the various proposals made during the food choice and preference preferences., Avoidance and approach indices, as well as indices of time spent looking at items in different food categories, measured by tracking eye movements and gaze fixation on food items presented during food choice and preference tests (using a TOBII-type eye tracker)., Psychometric scales to characterize eating disorders and anxiety: EDI (Eating Disorder Inventory), DEBQ (Dutch Inventory), DEBQ (Dutch Eating Behavior Questionnaire), Spielberger Anxiety Scale (STAI), Beck Depression Scales, to measure and monitor subjects' depressive state which can be a confounding factor, since it is frequently since it is frequently associated with anxiety., Hormonal and nutritional parameters.

Source: https://euclinicaltrials.eu/ctis-public/view/2024-519848-33-00